EU clinical trial 2023-506537-29-00: A multinational, prospective, open-label, roll-over study (LIBERTY) to provide post-trial access to treatment for patients with haemophilia A who have completed a previous trial with efanesoctocog alfa
Protocol code: Sobi.BIVV001-002
Sponsor: Swedish Orphan Biovitrum AB (publ) (Pharmaceutical company). Phase: Therapeutic confirmatory (Phase III). Countries: Italy (ongoing, recruiting), Spain (ongoing, recruitment ended), Germany (ended), Bulgaria (ongoing, recruitment ended), France (ongoing, recruitment ended), Greece (ongoing, recruitment ended), Slovenia (ended), Netherlands (ended), Sweden (ongoing, recruiting), Norway (ongoing, recruiting).
Therapeutic area(s): Diseases [C] - Congenital, Hereditary, and Neonatal Diseases and Abnormalities [C16]
Gender: Male. Age: 0-17 years, 18-64 years, 65+ years. Enrolment: 131.
Start date (EU): 2025-02-24. Decision date: 2024-04-11. Results received: No. Last updated: 2026-06-01.
Decision dates by country: DE: 2024-04-11, SI: 2025-02-26, NL: 2025-03-17, FR: 2025-04-07, GR: 2025-03-10, NO: 2025-09-18, IT: 2024-04-15, ES: 2024-04-11, SE: 2025-07-29, BG: 2025-03-24

Condition(s): Haemophilia A
Product: ALTUVOCT 4 000 IU powder and solvent for solution for injection, ALTUVOCT 500 IU powder and solvent for solution for injection, ALTUVOCT 2 000 IU powder and solvent for solution for injection, ALTUVOCT 1 000 IU powder and solvent for solution for injection, ALTUVOCT 3 000 IU powder and solvent for solution for injection, ALTUVOCT 250 IU powder and solvent for solution for injection

Primary endpoint: Safety Endpoint: The occurrence of adverse events (AEs), including serious adverse events (SAEs) and AESIs, Efficacy Endpoints: To collect further data on the efficacy of efanesoctocog alfa as a prophylaxis treatment; To collect further data on the efficacy of efanesoctocog alfa in the treatment of bleeding episodes

Source: https://euclinicaltrials.eu/ctis-public/view/2023-506537-29-00